EU clinical trial 2025-524182-25-00: Waiting on Atrial fibrillation Intervention Therapy (WAIT) Study
Sponsor: Karolinska University Hospital (Hospital/Clinic/Other health care facility). Phase: Therapeutic use (Phase IV). Countries: Sweden (authorised, recruitment pending).
Therapeutic area(s): Diseases [C] - Cardiovascular Diseases [C14]
Gender: Female, Male. Age: 18-64 years, 65+ years. Enrolment: 200.
Status: Authorised, recruitment pending. Decision date: 2025-12-17. Results received: No. Last updated: 2025-12-17.

Condition(s): Atrial fibrillation
Product: Wegovy 0.5 mg FlexTouch solution for injection in pre-filled pen

Primary endpoint: Primary variable: Freedom from atrial fibrillation, atrial flutter, or atrial tachycardia lasting ≥30 seconds as detected by continuous monitoring via implantable loop recorder at 12 months post-ablation. Events within the initial 3-month blanking period will not be included.

Source: https://euclinicaltrials.eu/ctis-public/view/2025-524182-25-00